EU clinical trial 2023-507305-33-00: A Phase I/IIa, First-in-human, Open-label, Dose Escalation and Expansion Study to Evaluate the Safety, Pharmacokinetics, Pharmacodynamics, and Preliminary Efficacy of AZD8421 Alone or in Combination in Participants with Selected Advanced or Metastatic Solid Tumors (CYCAD-1)
Protocol code: CYCAD-1(D8470C00001)
Sponsor: Astrazeneca AB (Pharmaceutical company). Phase: Phase I and Phase II (Integrated)- First administration to humans. Countries: Spain (ongoing, recruiting).
Therapeutic area(s): Diseases [C] - Neoplasms [C04]
Gender: Female. Age: 18-64 years, 65+ years. Enrolment: 28.
Status: Ongoing, recruiting. Start date (EU): 2024-04-29. Decision date: 2024-03-01. Results received: No. Last updated: 2026-07-20.
Decision dates by country: ES: 2024-06-06

Condition(s): Patients with ER+ HER2- advanced breast cancer and patients with high-grade serious ovarian cancer (HGSOC)
Product: PALBOCICLIB, PALBOCICLIB, AZD8421, PALBOCICLIB, AZD8421, Zoladex 3,6 mg implante en jeringa precargada, Camizestrant, ABEMACICLIB, PALBOCICLIB, PALBOCICLIB, AZD8421, PALBOCICLIB, RIBOCICLIB, ABEMACICLIB, ABEMACICLIB

Primary endpoint: Incidence of AEs, SAEs and DLTs, Clinically significant changes from baseline in clinical laboratory parameters, vital signs, and ECG results, Discontinuation of AZD8421 due to toxicity
Endpoint(s): Efficacy: According to the RECIST v1.1 by Investigator assessment (Eisenhauer et al 2009): • ORR • BOR • DoR • DCR at 24 weeks • Percentage change in tumor size • PFS, Summary PK profiles and descriptive statistics of After first dose: following PK parameters may be evaluated for AZD8421; Cmax, AUCinf, AUClast, tmax, λz, t½λz, CL/F, V/F, and Vz/F (additional PK parameters may be determined where appropriate). If data allows following PK parameters for metabolite(s) may be evaluated; Cmax, AUCinf, AUClast, tmax, t½λz (additional PK parameters may be determined where appropriate)., continued...After multiple doses: following PK parameters may be evaluated for AZD8421; Cssmax, AUC0-tau, AUCsslast, AUCss0-t, tssmax, t½λssz, CLss/F, Vss/F (additional PK parameters may be determined where appropriate) If data allows following PK parameters for metabolite(s) may be evaluated; Cssmax, AUC0-tau, AUCsslast, tssmax, t½λssz, CLss/F, Vss/F, ARCmax, ARAUC (additional PK parameters may be determined where appropriate), Module 1B only: Tumor protein analysis of the candidate biomarker and broader proteomic and phosphoproteomic profiling. Tumor and peripheral assessment including, but not limited to, DNA, mRNA, protein, epigenetic, and immune analyses.

Source: https://euclinicaltrials.eu/ctis-public/view/2023-507305-33-00